EU clinical trial 2024-519258-35-00: PRODIGE 111 – DOMZIGAST A randomized phase II study evaluating FOLFIRI vs FOLFIRI plus Domvanalimab (anti-TIGIT) and Zimberelimab (anti-PD1) in patients with advanced gastric or gastro-oesophageal junction adenocarcinoma with progression during or after peri-operative chemotherapy.
Protocol code: PRODIGE 111
Sponsor: Fondation Franc.Cancerologie Digestive (Hospital/Clinic/Other health care facility). Phase: Therapeutic exploratory (Phase II). Countries: France (ended).
Therapeutic area(s): Diseases [C] - Digestive System Diseases [C06]
Gender: Female, Male. Age: 18-64 years, 65+ years. Enrolment: 95.
Status: Ended. End date (EU): 2025-12-12. Decision date: 2025-10-08. Results received: No. Last updated: 2025-10-08.

Condition(s): stomach cancer, Esophage, gastro-oesophageal junction adenocarcinoma
Product: IRINOTECAN, FOLINIC ACID, FLUOROURACIL, DOMVANALIMAB, FLUOROURACIL, ZIMBERELIMAB

Primary endpoint: The primary endpoint is the percentage of patients alive without progression at 6 months (PFS at 6 months) after the randomization. Progression is defined as radiological progression according to RECIST version 1.1 criteria from morphological assessment, according to the investigator, or death, whatever the reason (which occurs first).
Endpoint(s): Overall survival (OS): OS is defined by the time between the date of randomization and the date of death (regardless of the cause). Alive patients will be censored at the date of their last news., Time To Progression (TTP): This time is defined by the time between the date of randomization and the date of the first radiological progression (according to RECIST v1.1) according to the investigator or death linked to cancer (which occurs first). Patients alive without radiological progression will be censored on the date of their latest CT-scan. Patients who died for other reason than cancer will be censored at the date of death, Progression-Free Survival (PFS): PFS is defined as the time between randomization and first radiological progression (according to RECIST 1.1) or death (whatever the cause). Patients alive without progression will be censored at the date of last news. Median PFS is evaluated as secondary endpoint., Best Objective Response Rate: It is the percentage of patients with Objective Response (OR) at the best response evaluation during the treatment according to RECIST v1.1 according to the investigator. The objective response is defined as partial or complete response. Patients without imaging or non-evaluable imaging will not be taken into account in the analysis., Safety profile: Adverse events (AE) will be evaluated according to NCI-CTC v5.0. All grade and severe (grade 3-5) AE will be recorded until 4 months after the last administration of treatment., Quality of life: Quality of life will be assessed according to the questionnaire of EORTC QLQ-C30 and QLQ-STO-22 scales (at baseline, 3, 6, and 12 months). Scores will be described at inclusion by treatment arm. The time to final deterioration of the global health score will be calculated.Alive patients without deterioration of this score will be censored at the time of the last questionnaire received. Patients without questionnaire during follow-up will be censored at the date of randomization.

Source: https://euclinicaltrials.eu/ctis-public/view/2024-519258-35-00